EU clinical trial 2023-509124-18-00: B7451031 - A Phase 3, Multicenter, Long-Term, Open-Label Study Evaluating the Safety and Efficacy of Abrocitinib, With or Without Topical Medications Administered to Pediatric Participants Aged 2 Years and Older With Moderate-to-Severe Atopic Dermatitis
Protocol code: B7451031
Sponsor: Pfizer Inc. (Pharmaceutical company). Phase: Therapeutic confirmatory (Phase III). Countries: Germany (authorised, recruitment pending), Poland (ongoing, recruiting), Hungary (ongoing, recruiting), Spain (ongoing, recruiting).
Therapeutic area(s): Diseases [C] - Skin and Connective Tissue Diseases [C17]
Gender: Female, Male. Age: 0-17 years. Enrolment: 185.
Start date (EU): 2025-12-19. Decision date: 2025-08-05. Results received: No. Last updated: 2026-07-08.
Decision dates by country: DE: 2025-08-05, ES: 2025-11-05, HU: 2025-08-18, PL: 2025-08-18

Condition(s): Moderate-to-Severe Atopic Dermatitis
Product: Abrocitinib

Primary endpoint: Overall treatment-emergent adverse events (TEAEs), serious adverse events (SAEs), and AEs that lead to discontinuation of study intervention.
Endpoint(s): Clinically significant laboratory abnormalities, Response based on achieving vIGA score of clear (0) or almost clear (1) (on a 5-point scale) and ≥2-point reduction from baseline1 at all scheduled time points., Response based on achieving a ≥4-point improvement from baseline1 in the Worst Itch-Numerical Rating Scale (WI-NRS) at all scheduled time points., Response based on achieving a ≥4-point improvement from baseline1 in the Worst Scratch/Itch-Numerical Rating Scale (WSI-NRS) at all scheduled time points., Response based on achieving ≥50%, ≥75%, ≥90%, 100% improvement from baseline1 in the Eczema Area and Severity Index (EASI) total score (EASI-50, EASI-75, EASI-90, EASI-100) at all scheduled time points., Percent change from baseline (CFB)1 in EASI total score at all scheduled time points., CFB1 in the percentage Body Surface Area (BSA) affected at all scheduled time points., Loss of response due to protocol-defined flare2, CFB1 in Children’s Dermatology Life Quality Index (CDLQI) at all scheduled time points., CFB1 in Infants’ Dermatitis Quality of Life (IDQOL) at all scheduled time points., CFB1 in Patient-Oriented Eczema Measure (POEM) at all scheduled time points., CFB1 in Dermatitis Family Impact (DFI) at all scheduled time points, CFB1 in Patient Reported Global Impression of Severity (PGIS) at all scheduled time points, CFB1 in Observer Reported Global Impression of Severity (OGIS) at all scheduled time points, CFB1 in the EuroQol- 5 Dimension Youth (EQ-5D-Y) at all scheduled time points, Number of topical corticosteroids- and / or topical calcineurin inhibitor-free days., Proportion of participants achieving satisfactory response in Tetanus, Diphtheria and Acellular Pertussis Vaccine (Tdap)/Diphtheria, Tetanus & Pertussis vaccine (DTaP) and/or pneumococcal antibody titers as appropriate in participants who receive Tdap/DTaP and/or pneumococcal vaccinations

Source: https://euclinicaltrials.eu/ctis-public/view/2023-509124-18-00